EU clinical trial 2024-513243-85-00: Chemotherapy for the treatment of standard risk adult medulloblastomas
Sponsor: CHRU De Nancy (Hospital/Clinic/Other health care facility). Phase: Therapeutic exploratory (Phase II). Countries: France (ongoing, recruitment ended).
Therapeutic area(s): Diseases [C] - Neoplasms [C04]
Gender: Female, Male. Age: 18-64 years, 65+ years. Enrolment: 45.
Status: Ongoing, recruitment ended. Start date (EU): 2023-02-03. Decision date: 2024-05-24. Results received: No. Last updated: 2024-05-24.

Condition(s): Adult medulloblastoma

Source: https://euclinicaltrials.eu/ctis-public/view/2024-513243-85-00